EU clinical trial 2023-503711-15-00: A Trial of Lu AG13909 in Participants with Congenital Adrenal Hyperplasia
Protocol code: 19873A
Sponsor: H. Lundbeck A/S (Pharmaceutical company). Phase: Phase I and Phase II (Integrated)- First administration to humans. Countries: Denmark (ended), Italy (ongoing, recruitment ended), Sweden (ongoing, recruitment ended), France (ongoing, recruitment ended), Poland (ongoing, recruitment ended), Ireland (ongoing, recruitment ended).
Therapeutic area(s): Diseases [C] - Congenital, Hereditary, and Neonatal Diseases and Abnormalities [C16]
Gender: Female, Male. Age: 18-64 years, 65+ years. Enrolment: 21.
Start date (EU): 2024-01-25. Decision date: 2023-05-10. Results received: No. Last updated: 2026-01-29.
Decision dates by country: DK: 2023-05-10, FR: 2025-08-13, IE: 2025-08-15, IT: 2023-10-18, SE: 2023-10-10, PL: 2025-08-18

Condition(s): Congenital adrenal hyperplasia

Source: https://euclinicaltrials.eu/ctis-public/view/2023-503711-15-00